EU clinical trial 2023-507970-42-00: PSMAddition: An International Prospective Open-label, Randomized, Phase III Study comparing 177Lu-PSMA-617 in combination with Standard of Care, versus Standard of Care alone, in adult male patients with Metastatic Hormone Sensitive Prostate Cancer (mHSPC)
Protocol code: CAAA617C12301
Sponsor: Novartis Pharma AG (Pharmaceutical company). Phase: Therapeutic confirmatory (Phase III). Countries: Czechia (ongoing, recruitment ended), Denmark (ongoing, recruitment ended), Spain (ongoing, recruitment ended), Germany (ongoing, recruitment ended), France (ongoing, recruitment ended), Sweden (ongoing, recruitment ended), Belgium (ongoing, recruitment ended), Netherlands (ongoing, recruitment ended), Austria (ongoing, recruitment ended), Poland (ongoing, recruitment ended).
Therapeutic area(s): Diseases [C] - Neoplasms [C04]
Gender: Male. Age: 18-64 years, 65+ years. Enrolment: 445.
Status: Ongoing, recruitment ended. Start date (EU): 2021-03-31. Decision date: 2024-01-30. Results received: No. Last updated: 2026-03-24.
Decision dates by country: PL: 2024-02-05, DE: 2024-01-31, NL: 2024-01-31, DK: 2024-01-30, ES: 2024-01-31, FR: 2024-01-30, BE: 2024-02-01, CZ: 2024-02-01, SE: 2024-02-05, AT: 2024-03-07

Condition(s): PSMA-positive metastatic hormone-sensitive prostate cancer (mHSPC)
Product: Locametz 25 micrograms kit for radiopharmaceutical preparation, ABIRATERONE, LEUPRORELIN, HISTRELIN, ENZALUTAMIDE, TRIPTORELIN, NILUTAMIDE, Pluvicto 1 000 MBq/mL solution for injection/infusion, GOSERELIN, DEGARELIX, BICALUTAMIDE, BUSERELIN, RELUGOLIX, APALUTAMIDE, DAROLUTAMIDE, FLUTAMIDE

Primary endpoint: Radiographic progression-free survival (rPFS) is defined as the time from the date of randomization to the date of first documented radiographic disease progression as assessed by blinded independent central review (BIRC) and as outlined in Prostate Cancer Working Group 3 (PCWG3) Guidelines (Scher et al 2016) or death due to any cause
Endpoint(s): Overall survival is defined as the time from the date of randomization to the date of death due to any cause, PSA90 response is defined as the proportion of patients who have a ≥90% decrease in PSA from baseline that is confirmed by a second (the next) PSA measurement ≥4 weeks later. PSA90 at 12, 24 and 48 weeks will be evaluated., Time to development of mCRPC is defined as the time from date of randomization to disease progression despite androgen deprivation therapy (ADT) presenting as either a continuous rise in serum prostate specific antigen (PSA) levels, the progression of pre-existing disease, and/or the appearance of new metastases., PFS is defined as the time from date of randomization to the date of first documented progression by investigator assessment (radiographic progression, clinical progression, PSA progression) or death from any cause, whichever occurs first, PFS2 is defined as time from date of randomization to the first documented progression by investigator assessment (radiographic progression, clinical progression, PSA progression) on next-line therapy or death from any cause, whichever occurs first., Proportion of patients with PSA < 0.2 ng/mL at 12, 24 and 48 weeks, ORR, DCR, TTR, DOR, TTSTP based on PCWG3- modified RECIST 1.1 by BIRC., Safety: incidence and severity of AEs and serious adverse event (SAE)s, changes in laboratory values, vital signs and ECGs. Any clinically significant lab, vital signs, ECG abnormalities will be captured as an AE., Tolerability: dose interruptions, reductions and dose intensity, HRQoL as assessed by Functional Assessment of Cancer Therapy Prostate (FACT-P), Brief Pain Inventory (Short Form (BPI-SF) and European Quality of Life (EuroQol) 5 Domain 5 Level scale (EQ-5D-5L), Time to SSE (TTSSE) defined as date of randomization to the date of first new symptomatic pathological bone fracture, spinal cord compression, tumor-related orthopedic surgical intervention, requirement for radiation therapy to relieve bone pain or death from any cause, whichever occurs first

Source: https://euclinicaltrials.eu/ctis-public/view/2023-507970-42-00